EU clinical trial 2023-503674-20-00: An Open-label, Randomized, Multicenter, Phase 3 Study to Assess the Efficacy and Safety of Trastuzumab Deruxtecan as First-line Treatment of Unresectable, Locally Advanced, or Metastatic NSCLC Harboring HER2 Exon 19 or 20 Mutations (DESTINY-Lung04)
Protocol code: D967SC00001
Sponsor: AstraZeneca AB (Pharmaceutical company). Phase: Therapeutic confirmatory (Phase III). Countries: France (ongoing, recruitment ended), Denmark (ongoing, recruitment ended), Poland (ongoing, recruitment ended), Italy (ongoing, recruitment ended), Belgium (ongoing, recruitment ended), Netherlands (ongoing, recruitment ended), Germany (ongoing, recruitment ended), Spain (ongoing, recruitment ended), Austria (ongoing, recruitment ended).
Therapeutic area(s): Diseases [C] - Neoplasms [C04]
Gender: Female, Male. Age: 18-64 years, 65+ years. Enrolment: 160.
Status: Ongoing, recruitment ended. Start date (EU): 2021-12-17. Decision date: 2024-07-11. Results received: No. Last updated: 2026-06-05.
Decision dates by country: DK: 2024-07-12, DE: 2024-07-11, FR: 2024-08-19, AT: 2024-07-17, ES: 2024-07-11, PL: 2024-08-04, BE: 2024-07-16, NL: 2024-07-11, IT: 2024-07-17

Condition(s): Unresectable, locally advanced, or metastatic Non-Small Cell Lung Cancer with HER2 exon 19 or 20 mutations
Product: PEMETREXED, PEMETREXED, PEMBROLIZUMAB, DS-8201a, CARBOPLATIN, CISPLATIN

Primary endpoint: Progression Free Survival (PFS) defined as time from randomization until progression per RECIST 1.1 as assessed by Blinded Independent Central Review (BICR) or death due to any cause.
Endpoint(s): 1. Overall Survival (OS) defined as time from randomization until date of death due to any cause., 2-1: PFS by investigator assessment defined as time from randomization until progression as assessed by investigator (per RECIST 1.1) or death due to any cause. Objective Response Rate (ORR) and Duration of Response (DoR) by BICR and Investigator assessment per RECIST 1.1. ORR is defined as proportion of participants who have a complete response (CR) or partial response (PR)., 2-2: DoR is defined as time from date of first documented response until date of documented progression. PFS2 is defined as time from randomization to second progression on next-line of treatment as assessed by investigator or death due to any cause., 2-3: PFS12 is the landmark of PFS which is defined as proportion of participants alive and progression-free at 12 months as assessed by BICR and investigator. OS24 is the landmark of OS defined as proportion of patients alive at 24 months, 3. CNS-PFS defined as time from randomization until CNS-progression (RECIST 1.1) as assessed by BICR or death due to any cause in absence of CNS progression., 4. AEs, SAEs, changes from baseline in laboratory parameters, vital signs, ECG, ECHO/MUGA results., 5. Pharmacokinetics (PK) of T-DXd and serum concentration of T-DXd, total anti-HER2 antibody and DXd, 6. Presence of ADAs for T-DXd, 7. Time to sustained deterioration in pulmonary symptoms while on treatment using NSCLC-Symptom Assessment Questionnaire (SAQ), 8. Patient Reported Tolerability will be described among participants using the following outcomes: Symptomatic AEs (assessed by PROCTCAE and EORTC Item Library), Overall Side Effect Bother (reported on Patient's Global Impression of Treatment Tolerability (PGI-TT)), Physical Function (based on EORTC-QLQ-30)

Source: https://euclinicaltrials.eu/ctis-public/view/2023-503674-20-00